EU clinical trial 2024-518929-15-00: A Phase 2a, Randomized, Double-blind, Placebo-controlled Study of the Safety, Tolerability, Pharmacokinetics, and Pharmacodynamics of ORX750 in Subjects with Narcolepsy and Idiopathic Hypersomnia – (CRYSTAL-1)
Protocol code: ORX750-0201
Sponsor: Centessa Pharmaceuticals UK Limited (Pharmaceutical company). Phase: Therapeutic exploratory (Phase II). Countries: Italy (ongoing, recruiting), France (authorised, recruitment pending), Spain (authorised, recruitment pending).
Therapeutic area(s): Diseases [C] - Nervous System Diseases [C10]
Gender: Female, Male. Age: 18-64 years, 65+ years. Enrolment: 46.
Start date (EU): 2025-06-09. Decision date: 2025-05-12. Results received: No. Last updated: 2026-07-16.
Decision dates by country: ES: 2025-05-16, IT: 2025-05-12, FR: 2025-05-12

Condition(s): Narcolepsy and Idiopathic Hypersomnia
Product: ORX750, ORX750, ORX750, ORX750, Orx750 matching placebo

Primary endpoint: Safety and Tolerability-incidence, severity, and causal relationship of TEAEs, including serious TEAEs; changes from baseline in laboratory tests (including biochemistry, haematology, and urinalysis), vital signs, weight, and 12-lead ECGs; and C-SSRS scores following treatment with cleminorexton versus treatment with placebo.
Endpoint(s): PK-Day 1: Cmax, tmax, and AUC0-last; Days 14 and 28: Cmax,ss, tmax, and AUCτ, and other PK parameters as appropriate., PD-mean sleep latency (average of the first 4 trials) in the MWT for cleminorexton versus placebo and subjective daytime sleepiness using the ESS, including change from baseline to specified postdose time points.

Source: https://euclinicaltrials.eu/ctis-public/view/2024-518929-15-00